EU clinical trial 2025-522953-21-00: A study in people with advanced cancer to test how well different doses of BI 3819026 are tolerated when taken alone and together with ezabenlimab
Protocol code: 2012-0001
Sponsor: Boehringer Ingelheim International GmbH, Boehringer Ingelheim Espana S.A. (Pharmaceutical company). Phase: Human Pharmacology (Phase I)- Other. Countries: Spain (ongoing, recruiting).
Therapeutic area(s): Diseases [C] - Neoplasms [C04]
Gender: Female, Male. Age: 18-64 years, 65+ years. Enrolment: 12.
Status: Ongoing, recruiting. Start date (EU): 2026-04-30. Decision date: 2026-04-13. Results received: No. Last updated: 2026-04-13.

Condition(s): unresectable advanced or metastatic solid cancer

Source: https://euclinicaltrials.eu/ctis-public/view/2025-522953-21-00